EU clinical trial 2024-511843-24-00: A first-in-human, open-label, clinical study to assess the safety, tolerability, and activity of OT-C001 (amplified/activated allogenic natural killer cells) in patients with relapsed/refractory diffuse large B-cell lymphoma
Protocol code: C00101
Sponsor: Emercell SAS (Pharmaceutical company). Phase: Human Pharmacology (Phase I)- First administration to humans. Countries: France (authorised, recruitment pending).
Therapeutic area(s): Diseases [C] - Hemic and Lymphatic Diseases [C15]
Gender: Female, Male. Age: 18-64 years, 65+ years. Enrolment: 10.
Status: Authorised, recruitment pending. Decision date: 2025-02-04. Results received: No. Last updated: 2025-07-15.

Condition(s): Relapsed/refractory (R/R) diffuse large B-cell lymphoma

Source: https://euclinicaltrials.eu/ctis-public/view/2024-511843-24-00